EU clinical trial 2024-517764-38-00: A combined treatment with GM-CSF, fosfomycin and metronidazole for pouchitis in ulcerative colitis patients after restorative ileal pouch anal anastomosis surgery. A clinical safety and proof-of-concept study
Sponsor: Region Sjaelland, Reponex Pharmaceuticals A/S (Hospital/Clinic/Other health care facility, Pharmaceutical company). Phase: Phase I and Phase II (Integrated)- Other. Countries: Denmark (ongoing, recruiting).
Therapeutic area(s): Diseases [C] - Digestive System Diseases [C06]; Diseases [C] - Immune System Diseases [C20]
Gender: Female, Male. Age: 18-64 years, 65+ years. Enrolment: 18.
Status: Ongoing, recruiting. Start date (EU): 2024-09-27. Decision date: 2024-09-27. Results received: No. Last updated: 2024-11-14.

Condition(s): Pouchitis
Product: METRONIDAZOLE, FOSFOMYCIN, MOLGRAMOSTIM

Primary endpoint: Change in the pouchitis disease activity index (PDAI
Endpoint(s): Change in the clinical, endoscopic or histological PDAI, Change in median WBC, CRP, creatinine and liver enzymes from before application of the study drug to 7 days after application of the study drug, Change in microbial diversity in the pouch using 16S rRNA sequencing from before application of the study drug to 7 days after application of the study drug, Safety: Determine serious adverse reactions or adverse reactions from the application of GM-CSF, metronidazole and fosfomycin in the pouch, Assess the modulation of dendritic cells and inflammatory mechanisms using Nanostring nCounter analysis through mRNA expression and flow cytometry

Source: https://euclinicaltrials.eu/ctis-public/view/2024-517764-38-00